EU clinical trial 2025-524575-22-00: A randomized double-masked, multicenter, 3-arm, pivotal Phase 2/3 study to evaluate the efficacy and safety of intravitreal (IVT) EYE201/MK-8748 compared to aflibercept (2 mg) in participants with neovascular age-related macular degeneration (NVAMD)
Protocol code: MK-8748-002
Sponsor: Eyebiotech Limited (Laboratory/Research/Testing facility). Phase: Phase II and Phase III (Integrated). Countries: Spain (ongoing, recruiting), Poland (authorised, recruitment pending), Estonia (authorised, recruitment pending), Latvia (authorised, recruiting), Germany (authorised, recruitment pending).
Therapeutic area(s): Diseases [C] - Eye Diseases [C11]
Gender: Female, Male. Age: 18-64 years, 65+ years. Enrolment: 130.
Start date (EU): 2026-06-30. Decision date: 2026-06-03. Results received: No. Last updated: 2026-06-12.
Decision dates by country: DE: 2026-06-08, LV: 2026-06-03, PL: 2026-06-05, EE: 2026-06-08, ES: 2026-06-04

Condition(s): Neovascular age-related macular degeneration (NVAMD)
Product: AFLIBERCEPT

Primary endpoint: Mean Change in Best-Corrected Visual Acuity (BCVA) [Early Treatment of Diabetic Retinopathy Study (ETDRS Letters)] From Baseline to Year 1

Source: https://euclinicaltrials.eu/ctis-public/view/2025-524575-22-00